EU clinical trial 2023-508897-27-00: C1071007 - MAGNETISMM-7 A RANDOMIZED, 2-ARM, PHASE 3 STUDY OF ELRANATAMAB (PF-06863135) VERSUS LENALIDOMIDE IN PATIENTS WITH NEWLY DIAGNOSED MULTIPLE MYELOMA AFTER UNDERGOING AUTOLOGOUS STEM-CELL TRANSPLANTATION
Protocol code: C1071007
Sponsor: Pfizer Inc. (Pharmaceutical company). Phase: Therapeutic confirmatory (Phase III). Countries: Czechia (ongoing, recruitment ended), Germany (ongoing, recruitment ended), Belgium (ongoing, recruitment ended), France (ongoing, recruitment ended), Norway (ongoing, recruitment ended), Spain (ongoing, recruitment ended), Netherlands (ongoing, recruitment ended), Austria (ongoing, recruitment ended), Poland (ongoing, recruitment ended), Italy (ongoing, recruitment ended), Finland (ongoing, recruitment ended), Hungary (ongoing, recruitment ended), Sweden (ongoing, recruitment ended), Greece (ongoing, recruitment ended).
Therapeutic area(s): Diseases [C] - Neoplasms [C04]
Gender: Female, Male. Age: 18-64 years, 65+ years. Enrolment: 377.
Status: Ongoing, recruitment ended. Start date (EU): 2022-04-28. Decision date: 2024-04-10. Results received: No. Last updated: 2026-07-20.
Decision dates by country: AT: 2024-04-15, CZ: 2024-04-11, NO: 2024-04-11, GR: 2024-06-28, HU: 2024-06-12, FR: 2024-04-10, BE: 2024-04-18, DE: 2024-04-17, PL: 2024-04-12, ES: 2024-04-10, FI: 2024-04-11, SE: 2024-04-11, NL: 2024-04-12, IT: 2024-04-22

Condition(s): Multiple Myeloma
Product: Zelvina 15 mg hard capsules, Privigen 100 mg/ml solution for infusion, ELRANATAMAB, Zelvina 5 mg hard capsules, Zelvina 10 mg hard capsules

Primary endpoint: • Progression-free survival (PFS) by Blinded Independent Central Review (BICR) per International Myeloma Working Group (IMWG)
Endpoint(s): Minimal residual disease (MRD)-negative rate at 12 months after randomization per IMWG as assessed via next-generation sequencing (NGS) • PFS by BICR per IMWG in IMWG 2025 high-risk participants • PFS by BICR per IMWG in IMWG 2025 standard-risk participants • Overall survival (OS)

Source: https://euclinicaltrials.eu/ctis-public/view/2023-508897-27-00